EU clinical trial 2024-517660-27-00: A Multicenter, Open-Label Study with a Randomized Control Arm of the Efficacy, Safety, and Pharmacokinetics of Intravenously Infused Berubicin in Adult Patients with Recurrent Glioblastoma Multiforme (WHO Grade IV) After Failure of Standard First Line Therapy
Protocol code: CNS-201
Sponsor: Cns Pharmaceuticals Inc. (Pharmaceutical company). Phase: Therapeutic exploratory (Phase II). Countries: Spain (ended), France (ended), Italy (ended).
Therapeutic area(s): Diseases [C] - Neoplasms [C04]
Gender: Female, Male. Age: 18-64 years, 65+ years. Enrolment: 126.
Status: Ended. Start date (EU): 2022-09-22. End date (EU): 2026-04-27. End date: 2026-04-28. Decision date: 2024-09-26. Results received: No. Last updated: 2026-03-12.
Decision dates by country: IT: 2024-10-18, ES: 2024-09-26, FR: 2024-10-02

Condition(s): Glioblastoma multiforme (GBM)
Product: Berubicin hydrochloride, Cecenu® 40 mg Kapsel

Primary endpoint: OS defined as the time from randomization until death.
Endpoint(s): PFS, defined as the length of time from randomization to disease progression based on MRI scan or death, whichever occurs first., EFS, defined as the length of time from randomization to disease progression, death, or discontinuation of treatment for any reason (e.g., toxicity, intolerance, disease-related conditions, or failure to respond), ORR, defined as CR + PR per RANO criteria, DCR, defined as CR + PR + SD per RANO criteria; SD is defined as lack of progression of disease based on MRI scan obtained at least (CCI) weeks after initiation of therapy

Source: https://euclinicaltrials.eu/ctis-public/view/2024-517660-27-00